EU clinical trial 2024-517216-29-00: A Phase I, Single-Arm, Sequential Study to Evaluate the Effect of Food on the Gastrointestinal Tolerability and Pharmacokinetics of Selumetinib after Multiple Doses in Adolescent Children with Neurofibromatosis Type 1 (NF1) Related Plexiform Neurofibromas (PN)
Protocol code: D1346C00015
Sponsor: AstraZeneca AB (Pharmaceutical company). Phase: Human Pharmacology (Phase I)- Other. Countries: Poland (ongoing, recruitment ended).
Therapeutic area(s): Not possible to specify
Gender: Female, Male. Age: 0-17 years, 18-64 years. Enrolment: 9.
Status: Ongoing, recruitment ended. Start date (EU): 2021-08-06. Decision date: 2024-11-18. Results received: No. Last updated: 2025-08-11.

Condition(s): Neurofibromatosis Type 1 (NF1) Related Plexiform Neurofibromas (PN)
Product: Koselugo 25 mg hard capsules, Koselugo 10 mg hard capsules

Primary endpoint: Geometric mean ratio of selumetinib AUC0-12, SS for T1 (fed) versus T2 (fasted)
Endpoint(s): Geometric mean ratio of selumetinib AUC0-12, SS for T3 (fed) versus T2 (fasted), Gastrointestinal AEs graded by CTCAE Version 5.0, Gastrointestinal toxicity diary incorporating the mBSFS-C and Nausea and Vomiting Symptom Rating Scale (adapted from the Children’s Cancer and Leukaemia Group), Usage of GI concomitant medication, Safety and tolerability will be evaluated in terms of AEs, clinical safety laboratory assessments (clinical chemistry, haematology, urinalysis), physical examination, weight, vital signs, ECG, ECHO or cardiac MRI, ophthalmologic assessment and performance status, Assessments related to AEs will include: occurrence/frequency; relationship to study intervention; CTCAE grade; seriousness; death; AEs leading to discontinuation of study intervention; AEs of special interest, Plasma concentrations and PK parameters of selumetinib and N-desmethyl selumetinib after multiple dose administration, including, but not limited to: Cmax, AUClast, tmax, tlast

Source: https://euclinicaltrials.eu/ctis-public/view/2024-517216-29-00